EU clinical trial 2023-503891-26-00: Investigation of safety, tolerability and pharmacokinetics of multiple doses of NNC0113‑6856 in healthy participants, including a subset of healthy Japanese participants
Protocol code: NN9904-5008
Sponsor: Novo Nordisk A/S (Pharmaceutical company). Phase: Human Pharmacology (Phase I)- Other. Countries: Germany (ended).
Therapeutic area(s): Diseases [C] - Nutritional and Metabolic Diseases [C18]
Gender: Female, Male. Age: 18-64 years. Enrolment: 170.
Status: Ended. Start date (EU): 2023-09-29. End date (EU): 2025-04-23. Decision date: 2023-08-25. Results received: No. Last updated: 2025-04-25.

Condition(s): Type 2 diabetes

Source: https://euclinicaltrials.eu/ctis-public/view/2023-503891-26-00